EU clinical trial 2023-505411-20-00: A Study to Investigate the Safety, Tolerability, and Pharmacokinetics of Zosurabalpin following Intravenous Administration in Healthy Participants
Protocol code: BP44773
Sponsor: F. Hoffmann-La Roche AG (Pharmaceutical company). Phase: Human Pharmacology (Phase I)- First administration to humans. Countries: Netherlands (ended).
Therapeutic area(s): Not possible to specify
Gender: Female, Male. Age: 18-64 years. Enrolment: 30.
Status: Ended. Start date (EU): 2023-09-20. End date (EU): 2024-03-28. Decision date: 2023-09-12. Results received: No. Last updated: 2024-03-28.

Condition(s): There is no medical condition being investigated. This is a safety and pharmacokinetic study to be performed in healthy participants.

Source: https://euclinicaltrials.eu/ctis-public/view/2023-505411-20-00